EU clinical trial 2024-515451-38-00: A Phase 3, Multicenter, Randomized, Double-Blinded, Placebo-Controlled, Parallel-Arm Study Followed by an Open-Label Arm to Evaluate the Efficacy and Safety of Efgartigimod IV in Adult Participants With Primary Immune Thrombocytopenia
Protocol code: ARGX-113-2402
Sponsor: Argenx (Pharmaceutical company). Phase: Therapeutic confirmatory (Phase III). Countries: Spain (ongoing, recruiting), Germany (ongoing, recruiting), Bulgaria (ongoing, recruiting), Poland (ongoing, recruiting), Romania (ongoing, recruiting), Ireland (ongoing, recruiting), Austria (authorised, recruiting), Italy (ongoing, recruiting), Czechia (authorised, recruiting), Croatia (ongoing, recruiting), Latvia (ended), France (authorised, recruiting), Hungary (authorised, recruiting), Portugal (ongoing, recruiting).
Therapeutic area(s): Diseases [C] - Immune System Diseases [C20]
Gender: Female, Male. Age: 18-64 years, 65+ years. Enrolment: 52.
Start date (EU): 2025-02-27. Decision date: 2025-01-24. Results received: No. Last updated: 2026-04-21.
Decision dates by country: LV: 2025-01-30, AT: 2025-01-29, BG: 2025-02-03, HR: 2025-02-03, CZ: 2025-03-28, FR: 2025-05-07, DE: 2025-01-31, HU: 2025-06-03, IE: 2025-02-04, IT: 2025-04-03, PL: 2025-01-29, PT: 2025-04-08, RO: 2025-02-03, ES: 2025-01-24

Condition(s): Primary Immune thrombocytopenia (ITP)
Product: Placebo for efgartigimod, ARGX-113, Vyvgart 20 mg/mL concentrate for solution for infusion

Primary endpoint: Extent of disease control, defined as the number of cumulative weeks during the Double-Blinded Treatment Period with platelet counts of at least 50 × 10^9/L.
Endpoint(s): Proportion of participants achieving platelet counts of at least 50 × 10^9/L for at least 4 of the 6 study visits between study weeks 19 and 24 of the DBTP, Proportion of participants achieving platelet counts of at least 50 × 10^9/L for at least 6 of the 8 study visits between study weeks 17 and 24 of the DBTP, Proportion of participants achieving platelet counts of at least 50 × 10^9/L for at least 8 of the 12 study visits between weeks 13 and 24 of the DBTP, Proportion of participants achieving a platelet count of at least 50 × 10^9/L on at least 4 occasions at any time until study week 12 during the DBTP, Time to response, defined as the time to achieve 2 consecutive platelet counts of at least 50 × 10^9/L at any time during the DBTP, Proportion of participants with an International Working Group (IWG) response during the DBTP, Proportion of participants with International Working Group (IWG) complete response during the DBTP, Proportion of participants with initial response, defined as a platelet count of at least 30 × 10^9/L and a 2-fold increase from baseline in platelet count at study week 5 of the DBTP, Time to achieve a platelet count of at least 30 × 10^9/L and a 2-fold increase from baseline in platelet count during the DBTP, Number of cumulative weeks during the DBTP with platelet counts of at least 30 × 10^9/L and ≥20 × 10^9/L above baseline, Number of cumulative weeks during the DBTP with platelet counts of at least 30 × 10^9/L and at least 20 × 10^9/L above baseline in participants with baseline platelet counts of <15 × 10^9/L, Extent of disease control, defined as the percentage of weeks with platelet counts of at least 50 × 10^9/L, In participants receiving placebo IV in the DBTP, the extent of disease control, defined as the number of cumulative weeks with platelet counts of at least 50 × 10^9/L, between weeks 13 and 24 of the OLTP1, Overall platelet count response, defined as the proportion of participants achieving a platelet count of at least 50 × 10^9/L on at least 4 occasions during the first 52 weeks of treatment with efgartigimod IV., Mean change from baseline in platelet count at each study visit, The percentage of weeks with platelet counts of at least 30 × 10^9/L and at least 20 × 10^9/L above baseline, In participants with baseline platelet counts <15 × 10^9/L, the percentage of weeks with platelet counts of at least 30 × 10^9/L and at least 20 × 10^9/L above baseline, Proportion of participants who achieve a sustained platelet count response, defined as achieving platelet counts of at least 50 × 10^9/L for at least 4 occasions during 6-week intervals., In participants receiving placebo IV in the DBTP, the proportion of participants achieving platelet counts of at least 50 × 10^9/L for at least 8 of the 12 study visits between weeks 13 and 24 of the OLTP1, In participants receiving placebo IV in the DBTP, the proportion of participants who achieve a sustained platelet count response, defined as achieving platelet counts of at least 50 × 10^9/L for at least 6 of the 8 study visits between weeks 17 and 24 of the OLTP1, In participants receiving placebo IV in the DBTP, the extent of disease control, defined as the number of cumulative weeks with platelet counts of at least 50 × 10^9/L during the first 24 weeks of treatment with efgartigimod IV, Occurrence rate of rescue ITP therapy, Proportion of participants with reduction in concurrent ITP therapy during the OLTP1, Incidence and severity of bleeding, assessed by the ITP Bleeding Scale (IBLS), Incidence and severity of adverse events (AEs) (including AEs of clinical interest) and serious AEs., Vital signs, laboratory safety measurements, physical examination, Incidence and prevalence of antidrug antibodies (ADA) against efgartigimod in serum over time, Incidence and prevalence of NAb against efgartigimod in serum over time, Efgartigimod Cmax and Ctrough over time, Percent change from baseline in total IgG levels in serum over time

Source: https://euclinicaltrials.eu/ctis-public/view/2024-515451-38-00